EU clinical trial 2022-500652-37-00: A MULTICOHORT, OPEN LABEL, PHASE 2 STUDY OF BOTENSILIMAB (AGEN1181) FOR TREATMENT OF ADVANCED MELANOMA REFRACTORY TO PRIOR CHECKPOINT INHIBITOR THERAPY
Protocol code: C-800-23
Sponsor: Agenus Inc. (Pharmaceutical company). Phase: Therapeutic exploratory (Phase II). Countries: Belgium (ended), Germany (ended), Italy (ended), Spain (ended), France (ended).
Therapeutic area(s): Diseases [C] - Neoplasms [C04]
Gender: Female, Male. Age: 18-64 years, 65+ years. Enrolment: 120.
Status: Ended. Start date (EU): 2022-12-01. End date (EU): 2026-05-05. Decision date: 2022-10-28. Results received: No. Last updated: 2026-04-13.
Decision dates by country: IT: 2022-10-31, BE: 2022-10-28, FR: 2022-11-03, ES: 2022-11-03, DE: 2022-10-31

Condition(s): Advanced melanoma refractory to prior checkpoint inhibitor therapy
Product: BALSTILIMAB, BOTENSILIMAB

Primary endpoint: 1. Objective response rate (ORR) as assessed by Response Evaluation Criteria in Solid Tumors Version 1.1 (RECIST 1.1) criteria.
Endpoint(s): 1. Progression-free survival (PFS), defined as the time from enrollment until disease progression or death, whichever comes first, quantified as a rate at 6 and 12 months., 2. Duration of response (DOR), defined as the time from first objective response until progression of disease or death, whichever comes first, quantified as median DOR., 3. Overall survival (OS) time, defined as the time from enrollment until death, whichever comes first, quantified as median OS.

Source: https://euclinicaltrials.eu/ctis-public/view/2022-500652-37-00